EU clinical trial 2023-505602-42-00: A Phase II, Open-label Study to Investigate the Pharmacokinetics and Safety of Risdiplam in Infants with Spinal Muscular Atrophy
Protocol code: BN44619
Sponsor: F. Hoffmann-La Roche AG (Pharmaceutical company). Phase: Therapeutic exploratory (Phase II). Countries: Norway (ended), Italy (ended), Belgium (ended), Germany (ended), Poland (ended), Netherlands (ended).
Therapeutic area(s): Diseases [C] - Nervous System Diseases [C10]
Gender: Female, Male. Age: 0-17 years. Enrolment: 8.
Status: Ended. Start date (EU): 2024-04-30. End date (EU): 2026-05-04. End date: 2026-05-05. Decision date: 2024-02-06. Results received: No. Last updated: 2026-03-26.
Decision dates by country: BE: 2024-03-18, NO: 2024-02-07, NL: 2024-03-17, PL: 2024-03-15, DE: 2024-02-06, IT: 2024-02-08

Condition(s): Spinal Muscular Atrophy (SMA)
Product: RO7034067, Evrysdi 0.75 mg/mL powder for oral solution

Primary endpoint: Plasma concentration of risdiplam and metabolite(s) as applicable at specified timepoints, AUC, Concentration at the end of a dosing interval to assess steady-state, Other PK parameters as appropriate, Risdiplam free fraction, Incidence and severity of adverse events, with severity determined according to the NCI CTCAE v5.0, Incidence and severity of serious adverse events, Incidence of treatment discontinuation due to adverse events, Incidence of abnormal laboratory values, Incidence of abnormal ECG values, Vital signs abnormalities, including body temperature, systolic and diastolic blood pressure, heart rate, respiratory rate, Physical examination, including detailed examination of the skin and mouth

Source: https://euclinicaltrials.eu/ctis-public/view/2023-505602-42-00